EU clinical trial 2023-503985-21-00: Performance and prognostic value of 68Ga-FAPI PET/CT in non-small cell lung cancer (NSCLC)
Protocol code: PROFILE
Sponsor: Meander Medisch Centrum (Hospital/Clinic/Other health care facility). Phase: Human Pharmacology (Phase I)- Other. Countries: Netherlands (ongoing, recruiting).
Therapeutic area(s): Analytical, Diagnostic and Therapeutic Techniques and Equipment [E] - Diagnosis [E01]; Diseases [C] - Neoplasms [C04]
Gender: Female, Male. Age: 18-64 years, 65+ years. Enrolment: 20.
Status: Ongoing, recruiting. Start date (EU): 2023-11-07. Decision date: 2023-08-21. Results received: No. Last updated: 2026-06-24.

Condition(s): Non small cell lung cancer

Source: https://euclinicaltrials.eu/ctis-public/view/2023-503985-21-00